EU clinical trial 2024-515901-24-00: Safety and efficacy of botulinum toxin A in patients with posttraumatic headache: a double-blind, randomized, placebo-controlled, parallel-group trial and investigation of neuro-inflammatory biomarkers as predictors of efficacy.
Protocol code: PTH Botox
Sponsor: Rigshospitalet (Hospital/Clinic/Other health care facility). Phase: Therapeutic confirmatory (Phase III). Countries: Denmark (ongoing, recruiting).
Therapeutic area(s): Diseases [C] - Nervous System Diseases [C10]
Gender: Female, Male. Age: 18-64 years, 65+ years. Enrolment: 80.
Status: Ongoing, recruiting. Start date (EU): 2025-01-10. Decision date: 2024-10-03. Results received: No. Last updated: 2026-06-24.

Condition(s): Persistent post-traumatic headache
Product: BOTULINUM TOXIN, Natriumklorid Fresenius Kabi 9 mg/ml

Primary endpoint: The proportion of responders in BTX-A and placebo group during the evaluation period (weeks 5 to 8) compared with baseline (weeks -4 to -1). A subject who meets the following criterion will be classified as a responder: Has a reduction of ≥ 30% in number of days having moderate or severe headache
Endpoint(s): The degree of change in inflammatory biomarkers (See protocol Section 7.2.14 for the full list) in plasma and tears in responders versus non-responders in BTX-A and placebo group., The proportion of responders in BTX-A and placebo group during the evaluation period (weeks 9 to 12) compared with baseline (weeks -4 to -1). proportion of subjects reaching ≥50% reduction in number of days with moderate-to-severe headache during the evaluation period (weeks 5 to 8) compared with baseline (weeks -4 to -1)., The proportion of subjects reaching ≥50% reduction in number of days with moderate-to-severe headache during the evaluation period (weeks 5 to 8) compared with baseline (weeks -4 to -1)., The proportion of subjects reaching ≥75% reduction in number of days with moderate-to-severe headache during the evaluation period (weeks 5 to 8) compared with baseline (weeks -4 to -1)., Proportion of subjects with a PGI-C scale response of “much improved” or “very much improved” at week 8 in BTX-A group and placebo group., Change from baseline to week 5 in the HIT-6, RPQ, HADS & ISI score in BTX-A and placebo group., Proportion of dropouts caused by increased intake of PTH medication or use of prohibited rescue medication in BTX-A group compared to the placebo group., Proportion of subjects with side effects registered in weeks 2 to 5 during treatment with BTX-A compared with placebo.

Source: https://euclinicaltrials.eu/ctis-public/view/2024-515901-24-00